EU clinical trial 2022-502886-71-00: A Phase 3, Randomized, Open Label Study to Compare Nivolumab plus Concurrent Chemoradiotherapy (CCRT) followed by Nivolumab plus Ipilimumab or Nivolumab plus CCRT Followed by Nivolumab vs CCRT followed by Durvalumab in Previously Untreated, Locally Advanced Nonsmall Cell Lung Cancer (LA NSCLC)
Protocol code: CA209-73L
Sponsor: Bristol Myers Squibb International Corporation (Pharmaceutical company). Phase: Therapeutic confirmatory (Phase III). Countries: France (ended), Netherlands (ended), Germany (ended), Spain (ended), Ireland (ended), Sweden (ended), Belgium (ended), Italy (ended), Romania (ended), Poland (ended), Greece (ended).
Therapeutic area(s): Diseases [C] - Neoplasms [C04]
Gender: Female, Male. Age: 18-64 years, 65+ years. Enrolment: 485.
Status: Ended. Start date (EU): 2019-11-20. End date (EU): 2024-03-12. End date: 2024-11-26. Decision date: 2023-04-11. Results received: Yes. Last updated: 2026-02-11.
Decision dates by country: SE: 2023-04-13, ES: 2023-04-17, GR: 2023-06-20, NL: 2023-04-11, IT: 2023-05-08, BE: 2023-05-12, FR: 2023-04-27, DE: 2023-04-26, RO: 2023-05-19, PL: 2023-05-23, IE: 2023-05-08

Condition(s): Previously Untreated Locally Advanced Non-small Cell Lung Cancer (LA NSCLC)
Product: Ipilimumab, Bendatax 6 mg/ ml, ETO-cell® 20 mg/ml Konzentrat zur Herstellung einer Infusionslösung, ALIMTA 500 mg powder for concentrate for solution for infusion, OPDIVO 10 mg/mL concentrate for solution for infusion., Cisplatin-Ebewe, 1 mg/ml, koncentrat do sporządzania roztworu do infuzji, DURVALUMAB, Cisplatin Teva® 1 mg/ml Konzentrat zur Herstellung einer Infusionslösung, CARBOPLATIN, Carboplatin Bendalis 10mg/ml, Konzentrat zur Herstellung einer Infusionslösung, Cisplatin NeoCorp 1 mg/ml - Konzentrat zur Herstellung einer Infusionslösung, PACLITAXEL, Paclitaxel Aurobindo 6 mg/ml Konzentrat zur Herstellung einer Infusionslösung, CISPLATIN, CARBO-cell® 10 mg/ml Infusionslösung, Konzentrat zur Herstellung einer Infusionslösung Carboplatin, ETOPOSIDE, Carbomedac® 10 mg/ml Konzentrat zur Herstellung einer Infusionslösung, PEMETREXED DISODIUM, IMFINZI 50 mg/mL concentrate for solution for infusion., Ipilimumab

Primary endpoint: Progression Free Survival (PFS) Assessed by RECIST 1.1 per Blinded Independent Central Review (BICR)
Endpoint(s): OS for Arm A vs Arm C, Overall Survival (OS) for Arm B and Arm C, Progression-free survival (PFS) by RECIST 1.1 per Blinded Independent Central Review (BICR) for Arm B and Arm C, Overall Survival (OS) for Arm A and Arm B, Progression-free survival (PFS) by RECIST 1.1 per Blinded Independent Central Review (BICR) for Arm A and Arm B, Objective Response Rate (ORR) by RECIST 1.1 per Blinded Independent Central Review (BICR), Duration of Response (DoR) by RECIST 1.1 per Blinded Independent Central Review (BICR), Time to Response (TTR) by RECIST 1.1 per Blinded Independent Central Review (BICR), Progression-free survival (PFS) by RECIST 1.1 per investigator assessment, Objective response rate (ORR) by RECIST 1.1 per investigator assessment, DoR by RECIST 1.1 per investigator assessment, TTR by RECIST 1.1 per investigator assessment, Time to death or distant metastases (TTDM) by RECIST 1.1 per Investigator assessment, Incidence of adverse events (AEs), Incidence of serious adverse events (SAEs), Proportion of participants without symptom deterioration based on NSCLC-SAQ

Source: https://euclinicaltrials.eu/ctis-public/view/2022-502886-71-00